EU clinical trial 2023-503678-18-00: An Exploratory, Multicenter, Randomized, double-blind, placebo-controlled study evaluating the effect and safety of pitolisant in children and adolescents with Autism Spectrum Disorders.
Protocol code: P21-01
Sponsor: Bioprojet Pharma (Pharmaceutical company). Phase: Therapeutic exploratory (Phase II). Countries: Spain (ended), France (ended), Italy (ended), Poland (ended).
Therapeutic area(s): Psychiatry and Psychology [F] - Behavior and Behavior Mechanisms [F01]; Psychiatry and Psychology [F] - Mental Disorders [F03]; Diseases [C] - Nervous System Diseases [C10]
Gender: Female, Male. Age: 0-17 years. Enrolment: 58.
Status: Ended. Start date (EU): 2023-10-10. End date (EU): 2025-11-03. End date: 2025-11-04. Decision date: 2023-08-14. Results received: Yes. Last updated: 2025-09-30.
Decision dates by country: FR: 2023-08-21, ES: 2023-08-14, IT: 2023-08-14, PL: 2025-01-27

Condition(s): Autism spectrum disorders
Product: Wakix 4.5 mg film-coated tablets, Wakix 18 mg film-coated tablets, Matching pitolisant film-coated tablets

Primary endpoint: Change from baseline of the Social Responsiveness Scale Second Edition (SRS-2) total score to the end of treatment period.
Endpoint(s): Change from baseline to the end of treatment period of SRS-2 Social Awareness sub-domain score, Change from baseline to the end of treatment period of SRS-2 Social Cognition sub-domain score, Change from baseline to the end of treatment period of SRS-2 Social Communication sub-domain score,, Change from baseline to the end of treatment period of SRS-2 Social Motivation sub-domain score, Change from baseline to the end of treatment period of SRS-2 Restricted Interests and Repetitive Behavior sub-domain score, Change from baseline to the end of treatment period of Vineland Adaptive Behavior Scale III (VABS III) total score, Change from baseline to the end of treatment period of Vineland Adaptive Behavior Scale III (VABS III) Communication sub-domain score, Change from baseline to the end of treatment period of Vineland Adaptive Behavior Scale III (VABS III) Daily Living Skills sub-domain score, Change from baseline to the end of treatment period of Vineland Adaptive Behavior Scale III (VABS III) Socialization sub-domain score,, Change from baseline to the end of treatment period of Child’s Sleep Habits Questionnaire (CSHQ) total score, Change from baseline to the end of treatment period of Conners 4 ADHD Index (Conners 4 AI) total score, Clinical Global Impression – Improvement (CGI-I) score at week 12 of treatment, Pharmacokinetics endpoint: Trough serum level of pitolisant prior to last IMP intake after 12 weeks of treatment., Incidence of treatment discontinuation due to adverse events (AEs) and adverse drug reactions (ADRs), Incidence of serious AEs, Incidence and severity of AEs, Incidence of AEs of special interest (AESI), Incidence of emergence or worsening of symptoms as measured by the Columbia-Suicide Severity Scale (C-SSRS), Incidence of abnormal vital signs: pulse rate, systolic blood pressure, diastolic blood pressure, Incidence of clinically significant abnormalities on 12-lead ECG parameters, Incidence of clinically significant abnormalities on laboratory parameters

Source: https://euclinicaltrials.eu/ctis-public/view/2023-503678-18-00